EU clinical trial 2023-505792-71-00: A clinical study to evaluate the Efficacy and Safety of Different Sequences of Ciltacabtagene Autoleucel (Cilta-cel), Talquetamab SC in Combination with Daratumumab SC (Tal-D) and Teclistamab SC in Combination with Daratumumab SC (Tec-D) Following Induction with Daratumumab, Bortezomib, Lenalidomide and Dexamethasone (DVRd) in Participants with Standard-risk Newly Diagnosed Multiple
Protocol code: 54767414MMY2093
Sponsor: Janssen - Cilag International (Pharmaceutical company). Phase: Therapeutic exploratory (Phase II). Countries: Germany (ongoing, recruitment ended), Spain (ongoing, recruitment ended).
Therapeutic area(s): Diseases [C] - Neoplasms [C04]
Gender: Female, Male. Age: 18-64 years, 65+ years. Enrolment: 12.
Status: Ongoing, recruitment ended. Start date (EU): 2025-03-13. Decision date: 2024-11-07. Results received: No. Last updated: 2026-02-17.
Decision dates by country: ES: 2025-01-17, DE: 2024-11-11

Condition(s): Multiple Myeloma

Source: https://euclinicaltrials.eu/ctis-public/view/2023-505792-71-00